EU clinical trial 2023-506757-38-00: PRIMROSE: A Modular Phase I/IIa, Multi-centre, Dose Escalation, and Expansion Study of AZD3470, a MTA Cooperative PRMT5 Inhibitor, as Monotherapy and in Combination with Anticancer Agents in Patients with Advanced/Metastatic Solid Tumours That are MTAP Deficient
Protocol code: PRIMROSE D9970C00001
Sponsor: Astrazeneca AB (Pharmaceutical company). Phase: Human Pharmacology (Phase I)- First administration to humans. Countries: France (authorised, recruitment pending), Spain (ongoing, recruiting), Netherlands (ongoing, recruiting).
Therapeutic area(s): Diseases [C] - Neoplasms [C04]
Gender: Female, Male. Age: 18-64 years, 65+ years. Enrolment: 40.
Start date (EU): 2024-11-14. Decision date: 2024-04-15. Results received: No. Last updated: 2026-02-20.
Decision dates by country: FR: 2024-04-19, ES: 2024-04-15, NL: 2024-05-22

Condition(s): Advanced/metastatic solid tumors that are MTAP deficient.
Product: DEXTROMETHORPHANE ELERTE 1,5 mg/ml, sirop, AZD3470, AZD3470, Midazolam-ratiopharm® 2 mg/ml orale Lösung

Primary endpoint: Incidence of adverse events (AEs) determined by the number of patients with adverse events by system organ class and preferred term., Incidence of serious adverse events (SAEs) determined by the number of patients with adverse events by system organ class and preferred term., Incidence of dose-limiting toxicities (DLT) as determined by number of patients with at least 1 dose-limiting toxicity (DLT) as defined by the clinical study protocol
Endpoint(s): Radiological response assessed by the Investigator evaluated according to RECIST v1.1 1. Objective response rate (ORR) - The percentage or number of participants who have a confirmed investigator assessed complete or partial response as determined by the investigator according to response criteria in solid tumors (RECIST v1.1)., Duration of response (DOR) - the time from date of first documented objective response (which is subsequently confirmed) until date of documented disease progression per Tumor RECIST v1.1 as assessed by the Investigator at local site or death due to any cause., Disease Control Rate (DCR) at 12 weeks- defined as the percentage of participants who have a confirmed CR or PR or who have SD per RECIST 1.1 as assessed by the Investigator at local site and derived from the raw tumor data for at least 11 weeks after date of first dose to allow for an early assessment within the assessment window., Best percentage change in tumor size - Percentage change from baseline in TL (target lesion) tumor-size is based on the RECIST 1.1 TL measurements as assessed by the Investigator., Progression Free Survival (PFS) - defined as time from date of first dose (nonrandomized study parts) or date of randomization (randomized study parts) until progression per RECIST v1.1 as assessed by the Investigator at local site, or death due to any cause., Overall Survival (OS) - defined as time from date of first dose (nonrandomized study parts) or date of randomization (randomized study parts) until the date of death due to any cause., Module 1 Endpoints Part A (Dose escalation) Measurement of PK parameters: Area under the concentration time curve (AUC), maximum observed plasma concentration of the study drug (Cmax), Time to maximum observed plasma concentration of the study drug (T-max), Terminal elimination half-life (t 1/2), amount of AZD3470 excreted in urine (Ae), renal clearance (Clr), (USA ONLY) Module 1 Endpoints Part A (DDI) - Plasma geometric mean ratio (Cmax and AUC) of Midazolam evaluated with and without AZD3470 - Plasma geometric mean ratio (Cmax and AUC) of Dextromethorphan evaluated with and without AZD3470 - Percentage change from baseline tumor SDMA as measured by immunohistochemistry.

Source: https://euclinicaltrials.eu/ctis-public/view/2023-506757-38-00